EU clinical trial 2025-524872-51-00: A multicentre randomized double-blind placebo-controlled 48-week superiority study to compare the efficacy and safety of rituximab versus placebo in rheumatoid arthritis-associated interstitial lung disease - the BELLRA trial.
Protocol code: BELLRA
Sponsor: Vaestra Goetalandsregionen (Hospital/Clinic/Other health care facility). Phase: Therapeutic use (Phase IV). Countries: Sweden (ongoing, recruiting).
Therapeutic area(s): Diseases [C] - Immune System Diseases [C20]; Diseases [C] - Musculoskeletal Diseases [C05]
Gender: Female, Male. Age: 18-64 years, 65+ years. Enrolment: 120.
Status: Ongoing, recruiting. Start date (EU): 2026-05-25. Decision date: 2026-02-27. Results received: No. Last updated: 2026-02-27.

Condition(s): Rheumatoid arthritis-associated interstitial lung disease (RA-ILD)
Product: RITUXIMAB, 0.9% Sodium Chlorine (no active substance)

Primary endpoint: Difference in mean absolute change of %pFVC from baseline to 48 weeks between RTX treatment and placebo (PBO) groups.
Endpoint(s): Absolute change in FVC (mL) at 24 and 48 weeks., Absolute change in %pDLCO (Hb-corrected) at 24 and 48 weeks., Proportions of patients with absolute decline ≥5% in %pFVC at 48 weeks (definition of clinically meaningful progression)., Proportions of patients with ≥10% relative decline in %pFVC or ≥5 to <10% relative decline in %pFVC and ≥15% relative decline in %pDLCO at 48 weeks (OMERACT definition of progression)., Proportions of patients with stable (<5% absolute change) or improved FVC (%p and mL) at 48 weeks., Time-to-event “progression ≥10% of %pFVC”., Absolute change (in meters) of 6MWT at 48 weeks., Absolute change in overall extent (% affected lung volume) of ILD-associated abnormalities (reticulations, ground glass, fibrosis, traction bronchiectasis, honey combing abnormalities) on HRCT of the lungs at 48 weeks by visual assessment of two radiologists with expertise in ILD., Absolute change in overall (and separate entities) extent (volume) of ILD-associated abnormalities at 48 weeks by lung texture analysis based on CALIPER of HRCT scans., Change in Health Assessment Questionnaire – disability index (HAQ-DI) at 24 and 48 weeks., Change in total (and separate; breathlessness and activities, chest symptoms and psychological) score of King’s Brief Interstitial Lung Disease Questionnaire (K-BILD) at 24 and 48 weeks., Change in total (and separate; physical and emotional) score of Dyspnea-12 Questionnaire (D-12) at 24 and 48 weeks., Change in score on Short Form 36 (SF36) health survey at 24 and 48 weeks., Change in Euro-Qol measure of HRQoL in 5 dimensions (EQ-5D) at 24 and 48 weeks., Frequency of all-cause mortality and all-cause hospitalization during the trial., Frequencies of adverse events (AE) and serious adverse events (SAE) during the trial., Change from baseline in disease activity by swollen and tender joint counts, erythrocyte sedimentation rate (ESR), c-reactive protein (CRP), disease activity score based on 28 joints (DAS28), DAS28-CRP, clinical disease activity index (CDAI) and Physician’s/Patient’s Global Assessment (PhGA/PGA) of RA disease activity on VAS at 24 and 48 weeks., Proportions of patients in DAS28-, CDAI- and ACR/EULAR Boolean 2.0 remission respectively at 48 weeks., Subgroup analysis based on baseline ILD type, ILD severity, joint disease activity and by presence of the ILD-associated MUC5B genetic variant., Change from baseline to 24 and 48 weeks of proposed ILD plasma biomarkers KL-6, surfactant protein-D, MMP-7 and CXCL10 as well as of unbiased plasma protein profiles.

Source: https://euclinicaltrials.eu/ctis-public/view/2025-524872-51-00